EU clinical trial 2024-514312-27-00: REINFORCE – Reducing infection-related readmissions following cystectomy. A multicentre randomised clinical trial testing superiority of individualised targeted antibiotic prophylaxis over empiric prophylaxis at ureteral stent removal to reduce infection-related readmissions following cystectomy.
Sponsor: Rigshospitalet (Hospital/Clinic/Other health care facility). Phase: Therapeutic use (Phase IV). Countries: Denmark (ongoing, recruiting).
Therapeutic area(s): Diseases [C] - Female Urogenital Diseases and Pregnancy Complications [C13]; Diseases [C] - Bacterial Infections and Mycoses [C01]; Diseases [C] - Male Urogenital Diseases [C12]
Gender: Female, Male. Age: 18-64 years, 65+ years. Enrolment: 248.
Status: Ongoing, recruiting. Start date (EU): 2025-01-07. Decision date: 2024-12-10. Results received: No. Last updated: 2026-02-13.

Condition(s): Bacterial infection
Product: Linezolid Teva 600 mg filmdragerade tabletter, Pivmecillinam hydrochloride Karo Pharma 400 mg film-coated tablets, Nitrofurantoin 50 mg tablets, Zinnat 500 mg, tbl flm, Ciprofloxacin 500 mg, film coated tablets, Bioclavid 500 mg/125 mg filmdragerade tabletter, Amoxicillin 500 mg film-coated tablets, Trimopan, filmovertrukne tabletter, Fluconazole 200 mg Capsules, Sulfametoxazol med trimetoprim SAD, tabletter

Primary endpoint: 90-day infection-related hospital readmission rate
Endpoint(s): Timing of ureteral stent removal and type of antimicrobial prophylaxis administered at ureteral stent removal, All-cause readmissions within 30 and 90 days after surgery, including main cause, timing, duration, microbiological tests, and antimicrobial treatment, Postoperative complications within 30 and 90 days of surgery using the Clavien-Dindo classification score, Days-alive-and-out-of-hospital (DAOH) at POD 30 and 90, Quality-of-life using the EORTC QLQ-C30 and QLQ-BLM30 questionnaires filled out preoperatively and on POD 90, Microbiological findings and antimicrobial susceptibility analyses in pre- and postoperative microbiological samples

Source: https://euclinicaltrials.eu/ctis-public/view/2024-514312-27-00